EU clinical trial 2024-515615-22-00: PHASE 2a OPEN-LABEL BASKET STUDY TO EVALUATE SAFETY AND PHARMACOKINETICS OF INF904, AN ORAL C5aR1 INHIBITOR, IN SUBJECTS WITH MODERATE TO SEVERE CHRONIC SPONTANEOUS URTICARIA OR HIDRADENITIS SUPPURATIVA
Protocol code: INF904-P2.1
Sponsor: InflaRx GmbH (Pharmaceutical company). Phase: Therapeutic exploratory (Phase II). Countries: Greece (ended), Poland (ended), Germany (ended), Bulgaria (ended).
Therapeutic area(s): Diseases [C] - Skin and Connective Tissue Diseases [C17]
Gender: Female, Male. Age: 18-64 years, 65+ years. Enrolment: 60.
Status: Ended. Start date (EU): 2025-04-02. End date (EU): 2026-01-15. End date: 2026-01-16. Decision date: 2025-03-06. Results received: Yes. Last updated: 2026-02-18.
Decision dates by country: GR: 2025-03-06, PL: 2025-03-16, BG: 2025-03-07, DE: 2025-04-29

Condition(s): Moderate to Severe Chronic Spontaneous Urticaria (CSU) or Moderate to Severe Hidradenitis Suppurativa (HS)
Product: INF904

Primary endpoint: Frequency, severity, and relatedness of treatment- emergent adverse events (TEAEs) and serious adverse events (SAEs) using MedDRA classification.
Endpoint(s): Plasma PK parameters of INF904 calculated as appropriate: • Maximum observed plasma concentrations (Cmax), • Minimum observed plasma concentration (Cmin), • Time of occurrence of maximum plasma concentration (tmax), • Systemic exposure, defined as the Area Under Curve AUC0-24, AUClast, PK parameters may also be derived from a Population PK (PopPK) model including AUCinf, AUC0--12 hr, AUC0-24 hr, Cmax, tmax, terminal half-life (t½), terminal elimination phase (Vz/F), and apparent oral clearance (CL/F).

Source: https://euclinicaltrials.eu/ctis-public/view/2024-515615-22-00